EU clinical trial 2024-511924-15-00: A Randomized, Controlled, Multicenter Study to Evaluate the Safety and Efficacy of Paltusotine in Subjects with Non-pharmacologically Treated Acromegaly (PATHFNDR-2)
Protocol code: CRN00808-08
Sponsor: Crinetics Pharmaceuticals Inc. (Pharmaceutical company). Phase: Therapeutic confirmatory (Phase III). Countries: Germany (ended), France (ended), Hungary (ended), Poland (ended), Italy (ended), Bulgaria (ended), Greece (ended).
Therapeutic area(s): Diseases [C] - Hormonal diseases [C19]
Gender: Female, Male. Age: 18-64 years, 65+ years. Enrolment: 61.
Status: Ended. Start date (EU): 2022-04-29. End date (EU): 2026-03-09. End date: 2026-06-02. Decision date: 2024-09-19. Results received: No. Last updated: 2026-04-08.
Decision dates by country: GR: 2024-12-10, DE: 2024-09-26, FR: 2024-09-24, IT: 2024-10-22, BG: 2024-10-04, PL: 2024-09-24, HU: 2024-09-19

Condition(s): Acromegaly
Product: Placebo to match Paltusotine tablets 20 mg, Paltusotine tablets

Primary endpoint: Proportion of subjects who achieve biochemical response in IGF-1 (≤ 1.0× the upper limit of normal [ULN]) at the End of the Randomized Control Phase (EOR).
Endpoint(s): Change from baseline in IGF-1, in units of ULN, to EOR., Proportion of subjects who achieve IGF-1 <1.3×ULN at EOR., Proportion of subjects with GH <1 ng/mL at Week 22., Change from baseline in Total Acromegaly Symptoms Diary (ASD) score to EOR.

Source: https://euclinicaltrials.eu/ctis-public/view/2024-511924-15-00